EU clinical trial 2025-523803-31-00: An Open-label, Multi-center, Global Phase II Clinical Study to Evaluate the Efficacy and Safety of HLX43 (Anti-PD-L1 ADC) in Subjects with Advanced Non-small Cell Lung Cancer (NSCLC)
Protocol code: HLX43-NSCLC201
Sponsor: Shanghai Henlius Biotech Inc. (Pharmaceutical company). Phase: Therapeutic exploratory (Phase II). Countries: Italy (ongoing, recruiting), Romania (ongoing, recruiting), Poland (authorised, recruiting), Spain (ongoing, recruiting), France (ongoing, recruiting).
Therapeutic area(s): Analytical, Diagnostic and Therapeutic Techniques and Equipment [E] - Therapeutics [E02]
Gender: Female, Male. Age: 18-64 years, 65+ years. Enrolment: 41.
Start date (EU): 2026-04-16. Decision date: 2026-03-25. Results received: No. Last updated: 2026-08-06.
Decision dates by country: RO: 2026-03-30, PL: 2026-05-15, IT: 2026-03-25, FR: 2026-05-15, ES: 2026-05-15

Condition(s): Advanced non-small cell lung cancer (NSCLC)
Product: HLX43 for Injection

Primary endpoint: Objective response rate (ORR) (assessed by the Blinded Independent Central Review [BICR] as per RECIST v1.1)
Endpoint(s): Overall survival (OS), Duration of response (DOR) and disease control rate (DCR) (assessed by the BICR and the investigator), Adverse events (AEs), serious adverse events (SAEs), laboratory tests, vital signs, 12-lead ECG, and physical examination, Blood drug concentration and pharmacokinetics parameters of HLX43 at different doses (ADC, total antibody, and free small molecule toxin), Positive rates of anti-HLX43 antibody (ADA) and neutralizing antibody (NAb), Potential predictive or drug resistance biomarkers, such as PD-L1 expression levels, tumor-related gene mutations or expression levels, serum proteomic profiles, Quality of life assessment, Objective response rate (ORR) (assessed by investigator as per RECIST v1.1), Progression-free survival (PFS) (assessed by the BICR and the investigator as per RECIST v1.1)

Source: https://euclinicaltrials.eu/ctis-public/view/2025-523803-31-00